EU clinical trial 2024-513726-33-00: Preventing liver recurrence after partial hepatectomy for intrahepatic cholangiocarcinoma using adjuvant hepatic arterial infusion pump chemotherapy – PUMP IV trial
Protocol code: PUMP IV
Sponsor: Erasmus Universitair Medisch Centrum Rotterdam (Erasmus MC) (Hospital/Clinic/Other health care facility). Phase: Therapeutic exploratory (Phase II). Countries: Netherlands (ongoing, recruiting).
Therapeutic area(s): Diseases [C] - Neoplasms [C04]; Analytical,Diagnostic,Therapeutic Techniques and Equipment [E]-Surgical Procedures, Operative [E04]; Diseases [C] - Digestive System Diseases [C06]
Gender: Female, Male. Age: 18-64 years, 65+ years. Enrolment: 40.
Status: Ongoing, recruiting. Start date (EU): 2024-10-25. Decision date: 2024-08-05. Results received: No. Last updated: 2025-05-09.

Condition(s): Intrahepatic cholangiocarcinoma (iCCA)

Primary endpoint: Two-year hepatic recurrence free survival (hRFS)
Endpoint(s): Overall recurrence free survival (RFS), Overall survival (OS), Postoperative complications, Chemotherapy related adverse events (AEs), Proportion of patients that started with adjuvant HAIP chemotherapy, Quality of life, Cost-effectiveness, Predictive biomarkers for the efficacy of HAIP chemotherapy

Source: https://euclinicaltrials.eu/ctis-public/view/2024-513726-33-00